EU clinical trial 2026-526237-26-00: A Trial to Evaluate the Safety and Drug Levels of Single and Multiple Oral Doses of AT-587 in Healthy Adults
Protocol code: AT-05E-001
Sponsor: Atea Pharmaceuticals Inc. (Pharmaceutical company). Phase: Human Pharmacology (Phase I)- First administration to humans. Countries: Belgium (ongoing, recruiting).
Therapeutic area(s): Diseases [C] - Virus Diseases [C02]
Gender: Female, Male. Age: 18-64 years, 65+ years. Enrolment: 62.
Status: Ongoing, recruiting. Start date (EU): 2026-07-13. Decision date: 2026-07-07. Results received: No. Last updated: 2026-07-07.

Condition(s): Chronic hepatitis E virus (HEV) infection

Source: https://euclinicaltrials.eu/ctis-public/view/2026-526237-26-00